EU clinical trial 2023-504839-40-00: A Phase III, Randomised, Double-blind, Placebo-controlled, Multicenter, Parallel-group Study with Extension Phase to Evaluate the Efficacy and Safety of Dysport for the Prevention of Episodic Migraine in Adult Participants
Protocol code: CLIN-52120-464
Sponsor: Ipsen Innovation (Pharmaceutical company). Phase: Therapeutic confirmatory (Phase III). Countries: Czechia (ongoing, recruitment ended), Poland (ended), France (ended), Germany (ongoing, recruitment ended), Spain (ongoing, recruitment ended).
Therapeutic area(s): Diseases [C] - Nervous System Diseases [C10]
Gender: Female, Male. Age: 18-64 years, 65+ years. Enrolment: 610.
Start date (EU): 2024-03-18. Decision date: 2023-11-22. Results received: No. Last updated: 2026-07-23.
Decision dates by country: PL: 2023-11-22, ES: 2023-11-22, DE: 2023-11-22, FR: 2023-11-23, CZ: 2023-11-22

Condition(s): Episodic Migraine
Product: Botulinum Toxin Type A 300 units Powder for solution for injection, Dysport Placebo Solution for injection, Botulinum Toxin Type A 500 units Powder for solution for injection

Primary endpoint: Change from baseline of monthly migraine days (MMD) Every 4 weeks from Week 4 (Weeks 1-4) to Week 24 (Weeks 21-24)
Endpoint(s): Change from baseline in MMD of ≥50% Every 4 weeks from Week 4 (Weeks 1-4) to Week 24 (Weeks 21-24).], Change from baseline in MMD of ≥75% Every 4 weeks from Week 4 (Weeks 1-4) to Week 24 (Weeks 21-24)], Cumulative number of MMD from Day 1 to Week 24, Change from baseline in MMD of moderate or severe intensity Every 4 weeks from Week 4 (Weeks 1-4) to Week 24 (Weeks 21-24), Change from baseline in MHD of moderate or severe intensity Every 4 weeks from Week 4 (Weeks 1-4) to Week 24 (Weeks 21-24), Change from baseline in MHD of moderate or severe intensity of ≥50% Every 4 weeks from Week 4 (Weeks 1-4) to Week 24 (Weeks 21-24), Change from baseline in MHD of moderate or severe intensity of ≥75% Every 4 weeks from Week 4 (Weeks 1-4) to Week 24 (Weeks 21-24), Cumulative number of MHD of moderate to severe intensity from Day 1 to Week 24, Change from baseline in the number of days per month of acute migraine specific medication intake Every 4 weeks from Week 4 (Weeks 1-4) to Week 24 (Weeks 21-24) • Acute migraine medication is defined as triptan, ergotamine, gepant, or ditan, Headache medication over user (yes, no) Every 4 weeks from Week 4 (Weeks 1-4) to Week 24 (Weeks 21-24) • defined as a participant with ≥10 days/month if ergotamine, triptan, gepant, ditan, opioid or combination analgesic, or ≥15 days/month if non-opioid analgesic (such as paracetamol, aspirin, NSAID), Use of acute migraine specific medication (yes, no) Every 4 weeks from Week 4 (Weeks 1-4) to Week 24 (Weeks 21-24), Patient’s Global Impression of Change PGIC score at Week 12 and Week 24, PGIC score of grade ≥1 and ≥2 at Week 12 and Week 24, Change from baseline in role function restrictive (RFR) domain of Migraine Specific Quality of Life Questionnaire (MSQ) At Week 12 and Week 24 (MSQ) At Week 12 and Week 24, Change from baseline in total MSQ score At Week 12 and Week 24, Change in MSQ score to the minimally important change (MIC) at Week 12 and Week 24, Change from baseline in total 6-item Headache Impact Text (HIT-6) score At Week 12 and Week 24, Change in total HIT-6 score to MIC threshold at Week 12 and Week 24, Change from baseline in SF-12 score at Week 12 and Week 24, Transition from baseline to Chronic migraine status at Week 12 and Week 24 (Weeks 21-24) • Chronic migraine status defined as a participant with ≥15 MHD and ≥8 MMD, Time to onset of effect (first time point post randomisation where MMD is reduced from baseline ≥50%), evaluated for MMD responders and all participants from first time point post randomisation to Week 24, Incidence of Treatment emergent adverse event (TEAEs) From baseline up to Week 24, Percentage of Participants with clinically significant changes in vital signs From baseline up to Week 24, Percentage of participants with clinically significant laboratory parameters (blood chemistry, haematology). From baseline up to Week 24, Treatment-emergence of suicidal ideation/suicidal behaviour from baseline to Week 24, Percentage of participants with antibodies to Dysport® at Week 24. Presence of binding antibodies will be assessed using a validated method of electrochemiluminescence assay (ECLA)., Percentage of participants with neutralising antibodies to Dysport® at Week 24. It will be performed only for confirmed positive samples with ECLA (confirmation of the presence of binding antibodies). Presence of neutralizing antibodies will be assessed using a validated cell-based assay (CBA)., Change from baseline in the number of MMD over the last 12 weeks prior to Week 24 (Weeks 13-24), Change from baseline in role function-preventive (RFP) domain of MSQ Questionnaire at Week 12 and Week 24, Change from baseline in emotional function (EF) domain of MSQ Questionnaire at Week 12 and Week 24

Source: https://euclinicaltrials.eu/ctis-public/view/2023-504839-40-00